EU clinical trial 2024-512179-11-00: SGLT2 inhibition in addition to lifestyle intervention and risk for complications in subtypes of patients with prediabetes - a randomized, placebo controlled, multi-center trial
Protocol code: Lifetime
Sponsor: Universitaetsklinikum Tuebingen AöR (Hospital/Clinic/Other health care facility). Phase: Therapeutic use (Phase IV). Countries: Germany (ongoing, recruiting).
Therapeutic area(s): Diseases [C] - Nutritional and Metabolic Diseases [C18]
Gender: Female, Male. Age: 18-64 years, 65+ years. Enrolment: 182.
Status: Ongoing, recruiting. Start date (EU): 2023-10-26. Decision date: 2024-10-10. Results received: No. Last updated: 2026-07-29.

Condition(s): Patients with prediabetes (defined as impaired fasting glucose [IFG] and/or impaired glucose tolerance [IGT])
Product: Placebo matching Dapagliflozin, Dapagliflozin Ascend 10 mg Filmtabletten

Primary endpoint: Frequency of remission of hyperglycemia in patients in highand low risk for CKD with prediabetes at EoT in thedapagliflozin versus the placebo group defined as a fastingglucose <100 mg/dl and 2 h glucose <140 mg/dl (Objective1)

Source: https://euclinicaltrials.eu/ctis-public/view/2024-512179-11-00